EU clinical trial 2023-509637-39-00: Proactive therapeutic drug monitoring versus routine care with the novel biologics in psoriasis: a pragmatic, multicentric, randomised, controlled study (HELIOS)
Sponsor: Universitair Ziekenhuis Gent (Hospital/Clinic/Other health care facility). Phase: Therapeutic use (Phase IV). Countries: Belgium (ongoing, recruiting).
Therapeutic area(s): Diseases [C] - Skin and Connective Tissue Diseases [C17]
Gender: Female, Male. Age: 18-64 years, 65+ years. Enrolment: 210.
Status: Ongoing, recruiting. Start date (EU): 2024-11-28. Decision date: 2024-08-27. Results received: No. Last updated: 2026-02-27.

Condition(s): moderate-to-severe psoriasis
Product: Tremfya 100 mg solution for injection in pre-filled syringe, Tremfya 100 mg solution for injection in pre-filled pen., Taltz 80 mg solution for injection in pre-filled pen, Taltz 80 mg solution for injection in pre-filled syringe, Cosentyx 300 mg solution for injection in pre-filled pen, Taltz 80 mg solution for injection in pre-filled pen, Cosentyx 150 mg solution for injection in pre-filled pen, Tremfya 100 mg solution for injection in pre-filled syringe, Taltz 80 mg solution for injection in pre-filled syringe, Tremfya 100 mg solution for injection in pre-filled pen., Cosentyx 150 mg solution for injection in pre-filled pen, Taltz 80 mg solution for injection in pre-filled syringe, Taltz 80 mg solution for injection in pre-filled syringe, Tremfya 100 mg solution for injection in pre-filled syringe, Cosentyx 300 mg solution for injection in pre-filled pen, Taltz 80 mg solution for injection in pre-filled pen, Taltz 80 mg solution for injection in pre-filled pen, Tremfya 100 mg solution for injection in pre-filled pen., Cosentyx 300 mg solution for injection in pre-filled pen, Tremfya 100 mg solution for injection in pre-filled syringe, Cosentyx 150 mg solution for injection in pre-filled pen, Cosentyx 150 mg solution for injection in pre-filled pen, Tremfya 100 mg solution for injection in pre-filled pen., Cosentyx 300 mg solution for injection in pre-filled pen

Primary endpoint: The primary endpoint is sustained disease control, defined as an absolute PASI ≤ 2 OR a delta PASI from baseline ≥ 50% during at least 80% of all 3-monthly study visits over a period of 18 months.
Endpoint(s): ● Change from baseline at 18 months in PASI score. The PASI measures disease activity. The scores ranges from 0 (skin lesion free) to 72 with higher scores indicating higher disease activity., ● Change from baseline at 18 months in DLQI_R score. The DLQI_R measures QoL. The score ranges from 0 (no impact) to 30 (greatest impact) with higher scores indicating higher impact on quality of life., ● Change from baseline at 18 months in SF-36 score. The SF-36 measures QoL. The score ranges from 0 (maximum disability) to 100 (no disability). In the field of dermatology, the SF36 has been proposed as the instrument of choice for evaluating QoL in a generic way by Both et al.. Although we acknowledge that the SF36 can be perceived as more difficult to fill in by the patients, comparison of QoL measures by Fernandez-Penas et al, showed that SF‐36 was more sensitive than other instruments in d, ● New onset or flare of arthritis, ● Drug discontinuation (incl. reasons), ● Serious adverse events (SAE), ● Adverse events of special interest (AEoSI) ○ occurrence of infusion reactions ○ infections, ● Cost of treatment (medication used and cost of TDM), ● Healthcare consumption (iMCQ), ● Number of dose modifications during the 18 months (0 – 6), ● Change from baseline at 18 months in TSQM score. The TSQM measures treatment satisfaction. TSQM is a 9-point questionnaire with scores ranging from 0 to 100. Higher scores indicate higher satisfaction., ● Change from baseline at 18 months in VAS score. The VAS measures treatment satisfaction. The VAS is a horizontal line of 100mm, with scores ranging from 0 (no satisfaction) to 10 (extreme satisfaction)., ● iMCQ and EQ-5D-5L to measure cost-effectiveness. Shikiar et al. showed that the EQ-5D index score is generally more highly correlated with clinical endpoints, compared with the SF-36, but displayed about the same degree of responsiveness. The MCID for the EQ-5D score is considered 6 units.

Source: https://euclinicaltrials.eu/ctis-public/view/2023-509637-39-00